EU clinical trial 2024-515149-41-00: Phase 1 Study of Oral LY3410738 in Patients with Advanced Hematologic Malignancies with IDH1 or IDH2 Mutations.
Protocol code: LOXO-IDH-20001
Sponsor: Eli Lilly & Co. (Pharmaceutical company). Phase: Human Pharmacology (Phase I)- First administration to humans. Countries: France (ongoing, recruitment ended).
Therapeutic area(s): Diseases [C] - Neoplasms [C04]
Gender: Female, Male. Age: 18-64 years, 65+ years. Enrolment: 34.
Status: Ongoing, recruitment ended. Start date (EU): 2021-02-04. Decision date: 2024-10-29. Results received: No. Last updated: 2026-06-09.

Condition(s): Advanced Hematologic Malignancies

Source: https://euclinicaltrials.eu/ctis-public/view/2024-515149-41-00